EU clinical trial 2025-522552-20-00: Multicenter, Randomized, Double-blind, Placebo-controlled Trial of Clemizole HCl as Adjunctive Therapy in Patients with Lennox-Gastaut Syndrome
Protocol code: EPX-100-003
Sponsor: Epygenix Therapeutics Inc. (Pharmaceutical company). Phase: Therapeutic confirmatory (Phase III). Countries: Italy (authorised, recruiting), Spain (ongoing, recruiting), Hungary (authorised, recruitment pending), Romania (ongoing, recruiting), Czechia (authorised, recruitment pending), Poland (ongoing, recruiting).
Therapeutic area(s): Diseases [C] - Nervous System Diseases [C10]
Gender: Female, Male. Age: 0-17 years, 18-64 years. Enrolment: 98.
Start date (EU): 2026-05-28. Decision date: 2026-04-28. Results received: No. Last updated: 2026-05-11.
Decision dates by country: IT: 2026-04-28, RO: 2026-05-04, PL: 2026-04-30, CZ: 2026-04-29, HU: 2026-04-30, ES: 2026-04-29

Condition(s): Lennox-Gastaut Syndrome
Product: Clemizole Hydrochloride placebo

Primary endpoint: Percent change in CMMS-28 from the Baseline Period through the end of the DB Period (Titration plus Maintenance Phase)
Endpoint(s): Proportion of participants with ≥50% reduction in CMMS-28 from the Baseline Period through the end of the DB Period (Titration plus Maintenance Phase), Percent change in CMMS-28 seizure-free days from the Baseline Period through the end of the DB Period (Titration plus Maintenance Phase), CGI-C score at the end of the DB Period (Titration plus Maintenance Phase), CaGI-C score at the end of the DB Period (Titration plus Maintenance Phase), CaGI-CSID score at the end of the DB Period (Titration plus Maintenance Phase), Change in QI-disability score from Baseline to the end of the DB Period (Titration plus Maintenance Phase), Percent change per 28 days in the number of seizure-free days (based on all seizure types) from the Baseline Period through the end of the DB Period (Titration plus Maintenance Phase), Percent change in CMMS-28 from the Baseline Period through the end of the DB Maintenance Phase only, Proportion of participants with ≥50% reduction in CMMS-28 from the Baseline Period through the end of the DB Maintenance Phase only, Incidence of TEAEs

Source: https://euclinicaltrials.eu/ctis-public/view/2025-522552-20-00